EU clinical trial 2024-516073-74-00: Surgical or radiotherapeutic intervention concerning large singular stable to progressive metastases in patients with BRAFV600-mutated melanoma receiving treatment with Encorafenib + Binimetinib
Protocol code: WKG 139175-52
Sponsor: SRH Wald-Klinikum Gera GmbH (Hospital/Clinic/Other health care facility). Phase: Therapeutic use (Phase IV). Countries: Germany (ended).
Therapeutic area(s): Diseases [C] - Neoplasms [C04]
Gender: Female, Male. Age: 18-64 years, 65+ years. Enrolment: 101.
Status: Ended. End date (EU): 2025-09-16. Decision date: 2025-01-23. Results received: No. Last updated: 2025-09-12.

Condition(s): Unresectable or metastatic melanoma with a BRAF V600 mutation (inoperable stage III or metastatic stage IV)
Product: ENCORAFENIB, BINIMETINIB

Primary endpoint: To determine progression free survival (PFS) after local treatment (radiotherapy / surgery / electrochemotherapy)
Endpoint(s): To evaluate response parameters: Overall Response Rate (ORR), Disease Control Rate (DCR), Duration of Response (DoR), Duration of Disease Control (DoDC), Duration of Stable Disease (DoSD), To determine progression-free survival rate (PFSR) at 1 year after local treatment (radiotherapy / surgery / electrochemotherapy), To determine time to treatment failure (TTF), To determine overall survival (OS), To evaluate Quality of Life (QoL) by means of questionnaires FACT-M, EQ-5D-5L, EORTC QLQ-C30, To evaluate safety / toxicity according to CTCAE Version 5.0 criteria: o Adverse events (overall and differentiated by patients undergoing surgery, radiotherapy or electrochemotherapy) o Adverse reactions concerning surgery, radiotherapy, electrochemotherapy, encorafenib and binimetinib, Exploratory study objectives: • To identify immune-related modes of treatment resistance, Exploratory study objectives: • To evaluate influence of the immune architecture of the metastases on the clinical outcome of patients

Source: https://euclinicaltrials.eu/ctis-public/view/2024-516073-74-00